EU clinical trial 2023-507974-42-00: A follow-up Phase II open-label study to evaluate the long-term safety and efficacy profile of ABX464 given at 25 mg once daily in subjects with Moderate to Severe Active Ulcerative Colitis
Protocol code: ABX464-108
Sponsor: Abivax (Pharmaceutical company). Phase: Therapeutic exploratory (Phase II). Countries: Slovakia (ongoing, recruitment ended), Spain (ended), Slovenia (ended), Belgium (ongoing, recruitment ended), France (ongoing, recruitment ended), Hungary (ongoing, recruitment ended), Austria (ongoing, recruitment ended), Czechia (ongoing, recruitment ended), Germany (ongoing, recruitment ended), Italy (ongoing, recruitment ended), Poland (ongoing, recruitment ended).
Therapeutic area(s): Diseases [C] - Digestive System Diseases [C06]
Gender: Female, Male. Age: 18-64 years, 65+ years. Enrolment: 161.
Start date (EU): 2021-12-01. Decision date: 2024-06-11. Results received: No. Last updated: 2026-04-20.
Decision dates by country: ES: 2024-06-12, SI: 2024-06-12, IT: 2024-07-02, HU: 2024-06-11, FR: 2024-06-12, PL: 2024-06-21, BE: 2024-06-11, DE: 2024-06-12, AT: 2024-06-17, CZ: 2024-06-12, SK: 2024-06-11

Condition(s): Moderate to Severe Ulcerative Colitis
Product: ABX464

Primary endpoint: Number of Adverse Events (AEs) in ABX464 treated subjects.

Source: https://euclinicaltrials.eu/ctis-public/view/2023-507974-42-00